EU clinical trial 2024-514358-56-00: Randomized, placebo-controlled, double-blind study to evaluate the efficacy of 2LHERP® in patients with recurrent orofacial herpes infections.
Sponsor: Labo'Life Belgium (Pharmaceutical company). Phase: Therapeutic use (Phase IV). Countries: Belgium (ongoing, recruiting).
Therapeutic area(s): Diseases [C] - Virus Diseases [C02]
Gender: Female, Male. Age: 0-17 years, 18-64 years. Enrolment: 140.
Status: Ongoing, recruiting. Start date (EU): 2024-06-19. Decision date: 2024-06-18. Results received: No. Last updated: 2026-05-19.

Condition(s): Patients presenting recurrent orofacial herpes infections (6 or more episodes within the 12 months period prior to study entry)
Product: Placebo, 2LHERP granules en gélules à ouvrir

Primary endpoint: Change from baseline within the number of episodes of herpes infections observed for 12 months, where the baseline value is the number of episodes experienced within the 12 months preceeding study enrolment.
Endpoint(s): a.1) Remaining herpes infection recurrence free 12 months after treatment initiation, a.2) Remaining herpes infection recurrence free 6 months after treatment initiation, a.3) Number of episodes of herpes infection observed at 6 months, b) Time to first recurrence of herpes infection during the treatment, c) Mean duration of episodes, d) Level of pain during episodes, e) Use of Rescue Medication, f) Quality of Life, e) Occurrence of AEs and SAEs

Source: https://euclinicaltrials.eu/ctis-public/view/2024-514358-56-00